EU clinical trial 2024-511852-42-00: A Randomized, Double-Blind, Placebo-Controlled, Study to Evaluate the Efficacy and Safety of Taldefgrobep Alfa in Ambulatory and Non-Ambulatory Participants with Spinal Muscular Atrophy with Open-Label Extension (RESILIENT)
Protocol code: BHV2000-301
Sponsor: Biohaven Pharmaceuticals Inc. (Pharmaceutical company). Phase: Therapeutic confirmatory (Phase III). Countries: Italy (ongoing, recruitment ended), Poland (ongoing, recruitment ended), Spain (ongoing, recruitment ended), Germany (ongoing, recruitment ended), Belgium (ongoing, recruitment ended), Czechia (ongoing, recruitment ended), Netherlands (ongoing, recruitment ended).
Therapeutic area(s): Diseases [C] - Musculoskeletal Diseases [C05]
Gender: Female, Male. Age: 0-17 years, 18-64 years. Enrolment: 104.
Status: Ongoing, recruitment ended. Start date (EU): 2023-01-19. Decision date: 2024-07-09. Results received: No. Last updated: 2026-05-05.
Decision dates by country: BE: 2024-07-16, ES: 2024-07-16, PL: 2024-08-06, NL: 2024-07-09, DE: 2024-07-11, IT: 2024-08-12, CZ: 2024-08-28

Condition(s): Spinal Muscular Atrophy
Product: Taldefgrobep, Placebo Solution for injection in pre-filled syringe, Taldefgrobep

Primary endpoint: Change from baseline in the MFM-32 at Week 48
Endpoint(s): Change from baseline in the RULM at Week 48, Change from baseline in the RHS at Week 48, Safety and tolerability assessments including change in lean body mass and bone mineral density on DXA scan from baseline at Week 48 and Tanner staging for puberty monitoring, monitoring of injection acceptability assessments, and frequency of unique subjects with: new or worsening lab abnormalities, treatment related adverse events, serious adverse events, and adverse events leading to discontinuation., Trough plasma concentrations of taldefgrobep alfa and pharmacokinetic parameters estimated with population PK modeling

Source: https://euclinicaltrials.eu/ctis-public/view/2024-511852-42-00